EU clinical trial 2024-511949-19-00: An Open-Label, Multicenter, Phase 1 Study Evaluating the Safety and Pharmacokinetics of ADU-1604 in Adults with Advanced Melanoma
Protocol code: SRP-21C101
Sponsor: Sairopa B.V. (Pharmaceutical company). Phase: Human Pharmacology (Phase I)- First administration to humans. Countries: France (ended), Poland (ended), Italy (ended), Spain (ended).
Therapeutic area(s): Diseases [C] - Neoplasms [C04]
Gender: Female, Male. Age: 18-64 years, 65+ years. Enrolment: 44.
Status: Ended. End date (EU): 2025-02-24. Decision date: 2024-06-18. Results received: No. Last updated: 2025-03-09.
Decision dates by country: ES: 2024-06-18, FR: 2024-06-21, PL: 2024-06-21, IT: 2024-06-20

Condition(s): Metastatic Melanoma

Source: https://euclinicaltrials.eu/ctis-public/view/2024-511949-19-00